EU clinical trial 2022-501012-34-00: A Randomized, Multicenter, Double-Blind, Placebo-Controlled, Parallel-Group Study with Open-Label Extension Period to Assess the Efficacy and Safety of Selexipag as Add-On Treatment to Standard of Care in Children Aged ≥2 to <18 years with Pulmonary Arterial Hypertension
Protocol code: AC-065A310
Sponsor: Actelion Pharmaceuticals Ltd. (Pharmaceutical company). Phase: Therapeutic confirmatory (Phase III). Countries: Spain (ongoing, recruitment ended), Ireland (ended), Belgium (ended), Bulgaria (ended), Hungary (ongoing, recruitment ended), Finland (ended), Italy (ongoing, recruitment ended), Lithuania (ended), France (ongoing, recruitment ended), Germany (ongoing, recruitment ended), Sweden (ended), Portugal (ongoing, recruitment ended), Poland (ongoing, recruitment ended).
Therapeutic area(s): Diseases [C] - Respiratory Tract Diseases [C08]
Gender: Female, Male. Age: 0-17 years. Enrolment: 73.
Start date (EU): 2020-02-27. Decision date: 2023-03-13. Results received: No. Last updated: 2026-04-27.
Decision dates by country: BE: 2023-03-20, BG: 2023-04-21, FI: 2023-03-16, FR: 2023-03-20, DE: 2023-03-14, LT: 2023-03-17, ES: 2023-03-14, SE: 2023-03-13, PL: 2023-04-24, IE: 2023-03-13, IT: 2023-03-14, PT: 2023-03-14, HU: 2023-03-16

Condition(s): Pulmonary Arterial Hypertension
Product: JNJ-67896049, PL3, PL1, JNJ-67896049, PL2, Tracleer 32 mg dispersible tablets, JNJ-67896049, PL4, JNJ-67896049

Primary endpoint: Time to disease progression from randomization up to 7 days after study treatment discontinuation.

Source: https://euclinicaltrials.eu/ctis-public/view/2022-501012-34-00